EU clinical trial 2024-510873-11-00: A phase II, double-blinded, placebo-controlled, clinical trial to determine the efficacy and safety of AP707 in the treatment of Borderline Personality Disorder.
Protocol code: Illuminate
Sponsor: Apurano Pharmaceuticals GmbH (Pharmaceutical company). Phase: Therapeutic exploratory (Phase II). Countries: Germany (authorised, recruitment pending).
Therapeutic area(s): Psychiatry and Psychology [F] - Mental Disorders [F03]
Gender: Female, Male. Age: 18-64 years. Enrolment: 154.
Status: Authorised, recruitment pending. Decision date: 2026-04-28. Results received: No. Last updated: 2026-04-28.

Condition(s): Borderline personality disorder
Product: AP707, Placebo

Primary endpoint: (i) Baseline adjusted difference (verum compared to placebo) in (mean) change from baseline in ZAN-BPD total score at EoT;, (ii) Baseline adjusted difference (verum compared to placebo) in (mean) change from baseline in BSL-23 total score at EoT.
Endpoint(s): 1. a) Proportion of ZAN-BPD responders (i.e., participants with ≥30% ZAN-BPD total score reduction at EoT compared to baseline) (verum compared to pla-cebo), 1. b) Proportion of ZAN-BPD responders (i.e., participants with ≥50% ZAN-BPD total score reduction at EoT compared to baseline) (verum compared to pla-cebo), 1. c) Time to first response of participants who experienced ≥30% ZAN-BPD total score reduction at EoT compared to baseline (verum com-pared to placebo), 1. d) Time to first response of participants who experienced ≥50% ZAN-BPD total score reduction at EoT compared to baseline (verum com-pared to placebo), 2. a) Proportion of BSL-23 responders (i.e., participants with ≥30% BSL-23 total score reduction at EoT compared to baseline) (verum compared to pla-cebo), 2. b) Proportion of BSL-23 responders (i.e., participants with ≥50% BSL-23 total score reduction at EoT compared to baseline) (verum compared to placebo), 2. c) Time to first response of participants who experienced ≥30% BSL-23 total score reduction at EoT compared to baseline (verum compared to pla-cebo), 2. d) Time to first response of participants who experienced ≥50% BSL-23 total score reduction at EoT compared to baseline (verum compared to placebo), 3. Baseline adjusted difference (verum compared to placebo) in (mean) change from baseline in CGI-S score at EoT (additionally: at V2, V3, …, V9), 4. Proportion of participants per PGI-C score at EoT, 5. a) Baseline adjusted difference (verum compared to placebo) in (mean) change from baseline in STAXI-2 (Trait-Anger) t-value at EoT, 5. b) Baseline adjusted difference (verum compared to placebo) in (mean) change from baseline in STAXI-2 (Anger Expression-Out) t-value at EoT, 5. c) Baseline adjusted difference (verum compared to placebo) in (mean) change from baseline in STAXI-2 (Anger Expression-In) t-value at EoT, 5. d) Baseline adjusted difference (verum compared to placebo) in (mean) change from baseline in STAXI-2 (Anger Control) t-value at EoT, 6. Baseline adjusted difference (verum compared to placebo) in (mean) change from baseline in DERS-36 total score at EoT, 7. a) Baseline adjusted difference (verum compared to placebo) in (mean) change from baseline in Patient Health Questionnaire (PHQ-9) total score at EoT, 7. b) Baseline adjusted difference (verum compared to placebo) in (mean) change from baseline in Montgomery-Åsberg Depression Rat-ing Scale (MADRS) total score at EoT, 8. a) Baseline adjusted difference (verum compared to placebo) in (mean) change from baseline in STAI (State-Anxiety) score at EoT, 8. b) Baseline adjusted difference (verum compared to placebo) in (mean) change from baseline in STAI (Trait-Anxiety) score at EoT, 9. a) Baseline adjusted difference (verum compared to placebo) in (mean) change from baseline in Barratt Impulsiveness Scale 15 (BIS-15) total score at EoT, 9. b) Baseline adjusted difference (verum compared to placebo) in (mean) change from baseline in impulsive sector score of ZAN-BPD at EoT, 10. Baseline adjusted difference (verum compared to placebo) in (mean) change from baseline in interpersonal sector score of ZAN-BPD at EoT, 11. Baseline adjusted difference (verum compared to placebo) in (mean) change from baseline in cognitive sector score of ZAN-BPD at EoT, 12. Baseline adjusted difference (verum compared to placebo) in (mean) change from baseline in affective sector score of ZAN-BPD at EoT, 13. Baseline adjusted difference (verum compared to placebo) in (mean) change from baseline in NRS-Pain score at EoT, 14. Number of participants with rescue medication over the course of the clinical trial and within periods: until Visit ≤ V2 (1 week), ≤ V3 (2 weeks), ≤ V4 (3 weeks), ≤ V5 (5 weeks), ≤ V6 (7 weeks), ≤ V7 (9 weeks), ≤ V8 (11 weeks), ≤ V9 (13 weeks), ≤ EoT (15 weeks), ≤ FU (18 weeks)

Source: https://euclinicaltrials.eu/ctis-public/view/2024-510873-11-00